EU clinical trial 2023-505054-17-00: ANTELOPE – Atezolizumab/Carboplatin/nab-Paclitaxel vs. Pembrolizumab/Platinum/Pemetrexed in metastatic TTF-1 negative lung adenocarcinoma
Protocol code: ANTELOPE
Sponsor: Charite Universitaetsmedizin Berlin KöR (Hospital/Clinic/Other health care facility). Phase: Therapeutic use (Phase IV). Countries: Germany (ongoing, recruitment ended).
Therapeutic area(s): Diseases [C] - Respiratory Tract Diseases [C08]
Gender: Female, Male. Age: 18-64 years, 65+ years. Enrolment: 136.
Status: Ongoing, recruitment ended. Start date (EU): 2023-09-15. Decision date: 2023-07-14. Results received: No. Last updated: 2026-06-23.

Condition(s): metastatic TTF-1 negative lung adenocarcinoma
Product: PEMETREXED, CISPLATIN, PEMBROLIZUMAB, PACLITAXEL ALBUMIN-BOUND, ATEZOLIZUMAB, CARBOPLATIN

Primary endpoint: Overall survival (OS)

Source: https://euclinicaltrials.eu/ctis-public/view/2023-505054-17-00